EU clinical trial 2024-517509-10-00: Laparoskooppisen paksusuoliresektion leikkauksen jälkeisten kivunhoitomenetelmien vertailu nykytiedon valossa
Sponsor: Pirkanmaan hyvinvointialue (Hospital/Clinic/Other health care facility). Phase: Therapeutic use (Phase IV). Countries: Finland (ended).
Therapeutic area(s): Analytical, Diagnostic and Therapeutic Techniques and Equipment [E] - Anesthesia and Analgesia [E03]
Gender: Female, Male. Age: 18-64 years, 65+ years. Enrolment: 255.
Status: Ended. Start date (EU): 2022-05-11. End date (EU): 2026-01-11. Decision date: 2024-09-16. Results received: No. Last updated: 2024-09-16.

Condition(s): Tutkittavat tulevat paksusuoliresektiotoimenpiteeseen joko paksusuolisyövän tai divertikuloosin vuoksi. Tutkimuksessa selvitetään puudutusmenetelmän vaikutusta toimenpiteen jälkeiseen kivunhoitoon.
Product: ROPIVACAINE

Primary endpoint: Aika puudutuksen laitosta (min) siihen, kun potilas ensimmäisen kerran kertoo kivun olevan enemmän kuin 3, jolloin tutkimusprotokollan mukaan annostellaan oksikodonia suonensisäisesti heräämössä tai osastolla suun kautta tai lihakseen, mikäli potilas kärsii hankalasta pahoinvoinnista kivun lisäksi.
Endpoint(s): - kipu 4 h välein sairaalassa ensimmäisen vuorokauden ajan, sitten kerran vuorossa (3x/vrk) /1 vko/4 viikkoa leikkauksen jälkeen(kontrollikäynti) (NRS 0-10), - kumulatiivinen opioidien tarve sairaalassaoloaikana, - pahoinvointi ja/tai oksentelu 4 h välein (kyllä/ei), - suolen toiminta (toimii/ei toimi), - potilastyytyväisyys käytettyyn puudutukseen (0-10 asteikko), - puudutukseen liittyvä komplikaatio, - leikkauskomplikaatiot Clavien-Dindo -luokituksen mukaan hoitotaulukosta, kyselykaavakkeet Suomen kivuntutkimusyhdistyksen kysely, BDI ja STAI ennen leikkausta ja 4 viikkoa leikkauksen jälkeen, - sairaanhoitajan tyytyväisyyskysely, -leikkauksen jälkeen viikon kestävä päiväkirja, sekä potilaan tyytyväisyyskysely

Source: https://euclinicaltrials.eu/ctis-public/view/2024-517509-10-00